EU clinical trial 2025-522892-27-00: A Phase 2 randomized, double-blind, placebo-controlled study to investigate efficacy, safety, immunogenicity, and pharmacokinetics, of GSK3862995B in participants with bronchiectasis
Protocol code: 223977
Sponsor: GSK PLC (Pharmaceutical company). Phase: Therapeutic exploratory (Phase II). Countries: Denmark (authorised, recruitment pending), France (authorised, recruitment pending), Spain (ongoing, recruiting), Italy (authorised, recruitment pending), Germany (ongoing, recruiting), Poland (ongoing, recruiting).
Therapeutic area(s): Diseases [C] - Respiratory Tract Diseases [C08]
Gender: Female, Male. Age: 18-64 years, 65+ years. Enrolment: 207.
Start date (EU): 2026-03-21. Decision date: 2026-02-09. Results received: No. Last updated: 2026-07-30.
Decision dates by country: FR: 2026-02-12, DE: 2026-02-13, IT: 2026-02-10, DK: 2026-02-09, ES: 2026-02-12, PL: 2026-02-12

Condition(s): Bronchiectasis
Product: 5% Dextrose Injection is a solution for injection

Primary endpoint: What is the percentage reduction in annualized exacerbation rate on GSK3862995B versus placebo, in adult patients with bronchiectasis and recurrent exacerbations or uncontrolled symptoms assuming no study treatment discontinuation occurred, change in maintenance SOC or use of prohibited medications.
Endpoint(s): 1. Annualized rate of exacerbationsa, 2. Time to first exacerbation, 3. Annualized rate of severe exacerbations

Source: https://euclinicaltrials.eu/ctis-public/view/2025-522892-27-00